EU clinical trial 2025-523180-38-00: A Phase 2b, Randomized, Double blind, Placebo controlled, Parallel group, Multicenter, Dose ranging Study Investigating the Efficacy and Safety Profile of KT-621 Administered Orally to Adult Participants with Uncontrolled Moderate to Severe Eosinophilic Asthma
Protocol code: KT621-AS-202
Sponsor: Kymera Therapeutics Inc. (Pharmaceutical company). Phase: Therapeutic exploratory (Phase II). Countries: Spain (ongoing, recruiting), Romania (ongoing, recruiting), Slovakia (ongoing, recruiting), Poland (ongoing, recruiting), Germany (ongoing, recruiting), Italy (authorised, recruitment pending), Belgium (authorised, recruitment pending), Austria (authorised, recruitment pending).
Therapeutic area(s): Diseases [C] - Immune System Diseases [C20]
Gender: Female, Male. Age: 18-64 years, 65+ years. Enrolment: 121.
Start date (EU): 2026-05-12. Decision date: 2026-04-10. Results received: No. Last updated: 2026-08-07.
Decision dates by country: DE: 2026-04-10, AT: 2026-04-19, SK: 2026-04-21, IT: 2026-04-14, ES: 2026-04-13, RO: 2026-04-17, BE: 2026-04-16, PL: 2026-04-23

Condition(s): Uncontrolled Moderate to Severe Eosinophilic Asthma
Product: KT-621, KT-621, Placebo oral tablet matched to KT-621, KT-621

Primary endpoint: Change from baseline to Week 12 in pre-bronchodilator FEV1.
Endpoint(s): Change from baseline to Week 12 in post-bronchodilator FEV1., Change from baseline to Week 12 in ACQ-5 score, Change from baseline to Week 12 in the AQLQ(S) Global Score, Incidence of TEAEs, Incidence of treatment-emergent SAEs, Plasma PK parameter estimates of KT-621 derived from plasma concentration time data

Source: https://euclinicaltrials.eu/ctis-public/view/2025-523180-38-00